EU clinical trial 2025-523653-34-00: Sublingual Birch Immunotherapy for Pollen-associated Food Allergy
Protocol code: SIPA1-2024
Sponsor: Klinikum der Technischen Universitaet Muenchen (TUM Klinikum) (Hospital/Clinic/Other health care facility). Phase: Therapeutic exploratory (Phase II). Countries: Germany (authorised, recruitment pending).
Therapeutic area(s): Diseases [C] - Immune System Diseases [C20]
Gender: Female, Male. Age: 18-64 years, 65+ years. Enrolment: 96.
Status: Authorised, recruitment pending. Decision date: 2026-05-29. Results received: No. Last updated: 2026-05-29.

Condition(s): Pollen-associated Food Allergy, Birch pollen Allergy
Product: ITULAZAX 12 SQ-Bet Lyophilisat zur sublingualen Anwendung, INFECTODIARRSTOP® LGG® Mono Beutel Pulver zur Herstellung einer Suspension zum Einnehmen für Säuglinge und Kleinkinder Wirkstoff: Lactobacillus rhamnosus GG (LGG) gefriergetrocknet, mindestens 5 x 109 KBE, Gelatine (fish, high molecular weight), Gelatine (fish, standard molecular weight), Mannitol, Sodium hydroxide, Purified water

Primary endpoint: Change from baseline to Visit 5 in the combined global VAS (itching, stinging, prickling within 5 minutes after apple challenge)
Endpoint(s): Change from baseline to Visit 5 in the combined global VAS (itching, stinging, prickling within 5 minutes after apple challenge), Change from baseline to Visit 5 in the Modified Bergmann Score, Change from baseline to Visit 5 in FAQLQ/FAIM total score, Change from baseline to Visit 5 in asthma symptoms and disease control total score (in asthmatic patients), Change from baseline to Visit 5 in RDF symptoms (in IBS subgroup), Incidence of solicited treatment-emergent local and systemic reactions (WAO grading), Incidence of unsolicited treatment-emergent AEs and SAEs, Incidence of anaphylaxis events, Physical examinations and vital signs, Use of rescue medication (Ceterizine, Prednisolon) to relief allergic symptoms as side effects, Use of emergency medication (systemic steroids, high-dose antihistamines or adrenaline) to treat side-effects of the apple challenge, Safety laboratory data, Likert Tolerability Scale Score for treatment, Change from baseline to Visit 5 in 5-point Likert Tolerability Scale Score after apple challange, Treatment adherence (days of IMP intake vs. non-intake, drug accountability)., Change from baseline to Visit 5 in systemic (serum concentrations of) total IgE, specific IgE, and IgG4 for Mal d1 and Bet v1

Source: https://euclinicaltrials.eu/ctis-public/view/2025-523653-34-00